EU clinical trial 2023-505187-11-00: Microdystrophin (GNT0004) Gene Therapy Clinical Trial in Duchenne Muscular Dystrophy: A phase I/II/III study with a dose determination part followed by an efficacy and safety evaluation, quadruple blind placebo-controlled part and then by a long term safety follow up part, in ambulant boys
Protocol code: GNT-016-MDYF
Sponsor: Genethon (Laboratory/Research/Testing facility). Phase: Phase I and Phase II (Integrated)- First administration to humans. Countries: France (ongoing, recruiting), Belgium (authorised, recruitment pending), Spain (authorised, recruitment pending).
Therapeutic area(s): Diseases [C] - Congenital, Hereditary, and Neonatal Diseases and Abnormalities [C16]
Gender: Male. Age: 0-17 years. Enrolment: 42.
Start date (EU): 2021-03-01. Decision date: 2023-06-21. Results received: No. Last updated: 2026-08-07.
Decision dates by country: BE: 2026-03-17, ES: 2026-04-08, FR: 2023-06-21

Condition(s): Duchenne Muscular Dystrophy
Product: Placebo AxMP is a solution intended to be administered by oral route for clinical purposes. Placebo AxMP is a pale yellow to yellow solution. Placebo AxMP composition corresponds to the excipients of the authorized product Rapamune® 1 mg/mL oral solution composed of a mixture of Phosal 50PG and Polysorbate 80., PREDNISOLONE, RINGER LACTATE FRESENIUS KABI FRANCE, solution pour perfusion, PREDNISOLONE, METHYLPREDNISOLONE, rAAV8-hMD1, Soliris 300 mg concentrate for solution for infusion, Rapamune 1 mg/mL oral solution

Primary endpoint: o NSAA: raw total score change from baseline versus placebo at month 18
Endpoint(s): - Safety and tolerability, measured by the incidence of adverse event (AE) or serious adverse event (SAE) evaluated by changes in laboratory parameters, vital signs and in the physical examination, PK/PD endpoints including vector shedding quantification in blood, urine, saliva, feces, Clinical efficacy endpoints including NSAA, Time to 10 Meters Walk/Run Test (10MWRT), Time to Rise From Floor (RFF), 6-Minutes Walk Test (6MWT)

Source: https://euclinicaltrials.eu/ctis-public/view/2023-505187-11-00